EU clinical trial 2022-501600-10-00: Stroke prophylaxis with Apixaban in Chronic Kidney Disease stage 5 patients with Atrial fibrillation (SACK)
Sponsor: Karolinska University Hospital, Medical University Of Silesia Katowice Poland (Hospital/Clinic/Other health care facility, Educational Institution). Phase: Therapeutic confirmatory (Phase III). Countries: Sweden (ongoing, recruiting), Iceland (ongoing, recruiting), Finland (ongoing, recruiting), Norway (ongoing, recruiting), Netherlands (ongoing, recruiting), Poland (ongoing, recruiting), France (authorised, recruitment pending).
Therapeutic area(s): Diseases [C] - Cardiovascular Diseases [C14]
Gender: Female, Male. Age: 18-64 years, 65+ years. Enrolment: 1281.
Start date (EU): 2023-02-07. Decision date: 2022-11-28. Results received: No. Last updated: 2026-06-23.
Decision dates by country: IS: 2022-11-28, NL: 2025-02-14, NO: 2022-11-29, FR: 2026-03-30, FI: 2022-11-29, PL: 2025-02-17, SE: 2022-11-28

Condition(s): Atrial fibrillation and Chronic Kidney Disease stage 5
Product: Eliquis 2.5 mg film-coated tablets, Apixaban Teva GmbH 2,5 mg filmdragerade tablette, Apixaban Accord 2.5 mg film-coated tablets

Primary endpoint: Ischemic stroke and systemic embolism (composite)
Endpoint(s): Composite event of intracranial bleeding (including hemorrhagic stroke) and fatal bleeding, Hospitalization for myocardial infarction, cardiovascular intervention, or cardiovascular death (composite), All-cause death, All-cause stroke or systemic embolism, Major bleeding (as defined in the International Society on Thrombosis and Haemostasias (ISTH) consensus)

Source: https://euclinicaltrials.eu/ctis-public/view/2022-501600-10-00